EU clinical trial 2024-512953-26-00: The ABC-HCC Trial: A Phase IIIb, randomized, multicenter, open-label trial of Atezolizumab plus Bevacizumab versus transarterial Chemoembolization (TACE) in intermediate-stage HepatoCellular Carcinoma
Protocol code: ABC-HCC
Sponsor: Frankfurter Institut Fuer Klinische Krebsforschung IKF GmbH (Pharmaceutical company). Phase: Therapeutic confirmatory (Phase III). Countries: Spain (ongoing, recruiting), France (ongoing, recruiting), Germany (ongoing, recruiting), Austria (ongoing, recruiting), Italy (ongoing, recruiting).
Therapeutic area(s): Diseases [C] - Neoplasms [C04]
Gender: Female, Male. Age: 18-64 years, 65+ years. Enrolment: 294.
Status: Ongoing, recruiting. Start date (EU): 2021-07-06. Decision date: 2024-11-01. Results received: No. Last updated: 2026-05-04.
Decision dates by country: IT: 2024-11-05, AT: 2024-11-05, ES: 2024-11-04, FR: 2024-11-07, DE: 2024-11-01

Condition(s): intermediate-stage hepatocellular carcinoma
Product: Avastin 25 mg/ml concentrate for solution for infusion., Tecentriq 1 200 mg concentrate for solution for infusion

Primary endpoint: Time to failure of treatment strategy (TTFS)
Endpoint(s): Overall Survival (OS), Overall Survival Rate at 24 months (OS@24), Objective Response Rate (ORR), Time to Progression (TTP), Time to loss of systemic treatment options (TTSYS), Progression free survival (PFS), Duration of Treatment, Duration of Response (DOR), Time to deterioration of liver function, Safety, QoL (Patient Reported Outcome; PRO), Baseline PD-L1 protein expression in FFPE tumor tissue

Source: https://euclinicaltrials.eu/ctis-public/view/2024-512953-26-00